EU clinical trial 2025-522275-28-00: Sample Collection Study to Monitor the Risk of Malignancy Due to Insertional Oncogenesis in Early Onset Patients with Metachromatic Leukodystrophy Treated with OTL-200 in the Clinical Development Program
Protocol code: OTL-200-11
Sponsor: Orchard Therapeutics (Europe) Limited (Pharmaceutical company). Phase: Therapeutic use (Phase IV). Countries: Netherlands (authorised, recruitment pending), Germany (authorised, recruitment pending), Italy (authorised, recruitment pending), Sweden (authorised, recruitment pending), France (authorised, recruitment pending).
Therapeutic area(s): Diseases [C] - Musculoskeletal Diseases [C05]
Gender: Female, Male. Age: 0-17 years, 18-64 years. Enrolment: 29.
Status: Authorised, recruitment pending. Decision date: 2026-06-22. Results received: No. Last updated: 2026-07-07.
Decision dates by country: FR: 2026-06-26, DE: 2026-06-23, IT: 2026-06-25, SE: 2026-06-22, NL: 2026-07-07

Condition(s): Metachromatic leukodystrophy
Product: Libmeldy 2-10 x 10^6 cells/mL dispersion for infusion

Primary endpoint: Incidence of malignancies due to insertional oncogenesis reported during the study
Endpoint(s): Incidence of clonal abundance ≥30% reported during the study.

Source: https://euclinicaltrials.eu/ctis-public/view/2025-522275-28-00